EU clinical trial 2024-512536-29-00: A phase 2, randomized, double-blind, placebo-controlled parallel group study of VHB937 in Amyotrophic Lateral Sclerosis (ALS) over 40 weeks followed by an Open-label Extension (ASTRALS)
Protocol code: CVHB937B12201
Sponsor: Novartis Pharma AG (Pharmaceutical company). Phase: Therapeutic exploratory (Phase II). Countries: Sweden (ongoing, recruitment ended), France (ongoing, recruitment ended), Germany (ongoing, recruitment ended), Denmark (ongoing, recruitment ended), Italy (ongoing, recruitment ended), Poland (ongoing, recruitment ended), Finland (ended), Spain (ongoing, recruitment ended), Netherlands (ongoing, recruitment ended), Belgium (ongoing, recruitment ended), Ireland (ongoing, recruitment ended).
Therapeutic area(s): Diseases [C] - Nervous System Diseases [C10]
Gender: Female, Male. Age: 18-64 years, 65+ years. Enrolment: 121.
Start date (EU): 2025-02-28. Decision date: 2025-01-15. Results received: No. Last updated: 2026-05-08.
Decision dates by country: FI: 2025-01-21, DK: 2025-01-18, ES: 2025-01-15, SE: 2025-01-20, NL: 2025-01-16, BE: 2025-01-16, FR: 2025-01-20, DE: 2025-01-17, IE: 2025-01-17, IT: 2025-01-17, PL: 2025-01-21

Condition(s): Amyotrophic Lateral Sclerosis (ALS)
Product: VHB937, Placebo 00 mg/ 00mL, concentrate for solution for infusion (Placebo to VHB937)

Primary endpoint: The composite of PAV-free survival and change in ALSFRS-R. Analysis method: Combined Assessment of Function and Survival (CAFS) [Time Frame: Baseline to DB Week 40]
Endpoint(s): ALSFRS-R total score [Time Frame: Baseline to DB Week 40 or until death or PAV (whichever occurs first); Baseline to OLE Week 100 or until death or PAV (whichever occurs first)], Slow Vital Capacity (SVC) (% of predicted normal value) [Time Frame: Baseline to DB Week 40 or until death or PAV (whichever occurs first); Baseline to OLE Week 100 or until death or PAV (whichever occurs first)], Ratio to baseline in Neurofilament Light (NfL) concentration in serum [Timeframe: DB up to Week 40; DB and OLE up to Week 100], Safety and tolerability parameters including adverse events, laboratory data, vital signs, electrocardiogram (ECG), Columbia Suicide Severity Rating Scale (C-SSRS) [Time Frame: Baseline to DB Week 40, Baseline to OLE Week 100, and Baseline to last scheduled visit or end of study], Time to death and Time to event (death or PAV, whichever comes first). [Timeframe: Baseline to DB Week 40], Time to death and Time to event (death or PAV, whichever comes first) – endpoints referring to treatment policy estimand [Time Frame: Baseline to OLE Week 100, and Baseline to end of study], Clinician and Patient Global Impression of change in functional ability and ALS symptom severity (CGI-C and PGI-C) [Time Frame: DB up to Week 40; DB and OLE up to Week 100], Change in QoL from baseline as measured with Amyotrophic Lateral Sclerosis Assessment Questionnaire -5 (ALSAQ-5), EuroQoL 5 Dimension 5 Level (EQ-5D-5L), 12-item Short form health survey (SF-12) [Time Frame: DB up to Week 40; DB and OLE up to Week 100], PK in serum and CSF and Anti-VHB937 antibodies (ADAs) in serum [Time Frame for serum: DB up to Week 40, DB and OLE up to Week 100; DB and OLE up to last scheduled visit; For CSF: DB Week 12]

Source: https://euclinicaltrials.eu/ctis-public/view/2024-512536-29-00